EU clinical trial 2023-504194-21-00: A Randomized, Open-label, Phase 3 Study of Sacituzumab Govitecan and Pembrolizumab Versus Treatment of Physician’s Choice and Pembrolizumab in Patients With Previously Untreated, Locally Advanced Inoperable or Metastatic Triple-Negative Breast Cancer, Whose Tumors Express PD-L1
Protocol code: GS-US-592-6173
Sponsor: Gilead Sciences Inc. (Pharmaceutical company). Phase: Therapeutic confirmatory (Phase III). Countries: Poland (ongoing, recruitment ended), Hungary (ongoing, recruitment ended), Spain (ongoing, recruitment ended), France (ongoing, recruitment ended), Austria (ongoing, recruitment ended), Netherlands (ongoing, recruitment ended), Belgium (ended), Czechia (ongoing, recruitment ended), Italy (ongoing, recruitment ended), Germany (ongoing, recruitment ended).
Therapeutic area(s): Diseases [C] - Neoplasms [C04]
Gender: Female, Male. Age: 18-64 years, 65+ years. Enrolment: 114.
Start date (EU): 2022-09-13. Decision date: 2024-11-04. Results received: No. Last updated: 2026-06-05.
Decision dates by country: NL: 2024-11-21, HU: 2024-11-05, IT: 2024-11-18, DE: 2024-11-05, ES: 2024-11-07, CZ: 2024-11-08, PL: 2024-11-05, AT: 2024-11-08, BE: 2024-11-04, FR: 2024-11-05

Condition(s): PD-L1 Positive Metastatic Triple-Negative Breast Cancer
Product: Paclitaxel 6 mg/ml concentrate for solution for infusion, KEYTRUDA 25 mg/mL concentrate for solution for infusion, Abraxane 5 mg/ml powder for dispersion for infusion., Gemcitabine 38 mg/mL concentrate for solution for infusion, Trodelvy 200 mg powder for concentrate for solution for infusion, Carboplatin 10 mg/ml concentrate for solution for infusion

Primary endpoint: PFS is defined as the time from the date of randomization until the date of objective progressive disease (PD), as assessed by BICR per RECIST Version 1.1, or death (whichever comes first)
Endpoint(s): OS is defined as the time from the date of randomization until death due to any cause., ORR is defined as the proportion of participants who achieve CR or PR that is confirmed at least 4 weeks after initial documentation of response as assessed by BICR per RECIST Version 1.1., DOR is defined as the time from the first documentation of CR or PR to the earlier of the first documentation of objective PD or death from any cause (whichever comes first) as assessed by BICR per RECIST Version 1.1., TTR is defined as the time from the date of randomization until the first documentation of CR or PR as assessed by BICR per RECIST Version 1.1., Incidence of TEAEs and clinical laboratory abnormalities., TTD of physical functioning domain of the EORTC QLQ-C30., TTD of role functioning, global health status/QOL, pain, and fatigue subscale domains of the EORTC QLQ-C30.

Source: https://euclinicaltrials.eu/ctis-public/view/2023-504194-21-00